EU clinical trial 2023-508504-38-00: Effect and safety of liraglutide 3.0 mg on weight management in children with obesity aged 6 to <12 years: 56-week, double-blind, randomised, placebo-controlled trial
Protocol code: NN8022-4392
Sponsor: Novo Nordisk A/S (Pharmaceutical company). Phase: Therapeutic confirmatory (Phase III). Countries: Portugal (ongoing, recruitment ended), Belgium (ongoing, recruitment ended).
Therapeutic area(s): Diseases [C] - Nutritional and Metabolic Diseases [C18]
Gender: Female, Male. Age: 0-17 years. Enrolment: 21.
Status: Ongoing, recruitment ended. Start date (EU): 2021-03-01. Decision date: 2024-01-24. Results received: No. Last updated: 2026-02-24.
Decision dates by country: PT: 2024-01-24, BE: 2024-02-01

Condition(s): Obesity
Product: Liraglutide placebo, Saxenda 6 mg/mL solution for injection in pre-filled pen

Primary endpoint: Relative change in BMI, from basekline (week 0) to week 56, in Percent
Endpoint(s): Confirmatory secondary endpoints: Relative change in body weight, from week 0 to week 56 in Percent, Subjects achieving ≥5% reduction of BMI, from week 0 to week 56 in, Yes/No, Supportive secondary endpoints Effect endpoints: Change in body weight, From baseline (week 0) to week 56, in kg, Change in BMI standard deviation score (WHO.int)6, From baseline (week 0) to week 56, Unitless, Subjects achieving ≥10% reduction of BMI, From baseline (week 0) to week 56, Yes/No, "BMI percentage of the 95th percentile on gender and age-specific growth charts (CDC.gov), From baseline (week 0) to week 56, in Percent point", Change in waist circumference, From baseline (week 0) to week 56, in cm, Change in systolic blood pressure, From baseline (week 0) to week 56, in mmHg, Change in diastolic blood pressure, From baseline (week 0) to week 56, in mmHg, Change in HbA1c, From baseline (week 0) to week 56, in Percent point, Safety endpoints: Treatment emergent adverse events (TEAEs), From baseline (week 0) to week 82, in Numbers, Treatment emergent serious adverse events (SAEs), From baseline (week 0) to week 82, in Numbers

Source: https://euclinicaltrials.eu/ctis-public/view/2023-508504-38-00